EU clinical trial 2024-511766-37-00: A Phase Ib/II Randomized, Double-Blind Study to Explore Safety, Tolerability, and Efficacy Signals of Multiple Doses of Striatally-Administered rAAV5-miHTT Total Huntingtin Gene (HTT) Lowering Therapy (AMT‑130) in Early Manifest Huntington Disease
Protocol code: CT-AMT-130-02
Sponsor: uniQure biopharma B.V. (Pharmaceutical company). Phase: Phase I and Phase II (Integrated)- First administration to humans. Countries: Poland (ongoing, recruitment ended).
Therapeutic area(s): Diseases [C] - Nervous System Diseases [C10]
Gender: Female, Male. Age: 18-64 years. Enrolment: 10.
Status: Ongoing, recruitment ended. Start date (EU): 2021-10-07. Decision date: 2024-07-29. Results received: No. Last updated: 2026-03-18.

Condition(s): Huntington’s Disease
Product: ifezuntirgene inilparvovec, ifezuntirgene inilparvovec

Primary endpoint: Type and incidence of AEs, Change from baseline in vital signs, electrocardiogram (ECG) parameters, physical examinations, and neurological examinations, Change from baseline in clinical chemistry and hematology safety laboratory tests, Change from baseline in routine urinalysis and CSF analysis, Change over time in AAV5 vector shedding, Change over time in antibodies against AAV5, cytokines, ELISpot, astroglial activation (glial fibrillary acidic protein [GFAP]), and microglial activation (YKL-40), Prospective assessment of suicidality via the Columbia-Suicide Severity Rating Scale (C-SSRS), Change from baseline to Day 14 and Month 1 in the MoCA, Change from baseline in edema, inflammation, volume loss and structural changes as measured by the following MRI pulse sequences: T1, T2, and diffusion magnetic resonance imaging (dMRI)
Endpoint(s): Change over time in levels of AMT-130–derived vector DNA and miRNA expression in the CSF in Cohorts 1 and 2 through approval of CT-AMT-130-02 Protocol Amendment 6.0 Version 7.0, Change over time in levels of only AMT-130-derived vector DNA in Cohorts 1 and 2 post-approval, and throughout the trial in Cohort 3.

Source: https://euclinicaltrials.eu/ctis-public/view/2024-511766-37-00